EU clinical trial 2026-525161-40-00: A Multicenter, Open-Label, Long-Term, Safety and Tolerability Extension Study of PTI5803 as adjunctive therapy in patients ≥ 14 years of age with drug-resistant seizures associated to focal cortical dysplasia.
Protocol code: A_CL_003
Sponsor: PannTheraPi (Pharmaceutical company). Phase: Therapeutic exploratory (Phase II). Countries: France (authorised, recruitment pending).
Therapeutic area(s): Diseases [C] - Nervous System Diseases [C10]
Gender: Female, Male. Age: 0-17 years, 18-64 years. Enrolment: 15.
Status: Authorised, recruitment pending. Decision date: 2026-07-31. Results received: No. Last updated: 2026-07-31.

Condition(s): Drug resistant focal epilepsy related to focal cortical dysplasia
Product: PTI5803

Primary endpoint: Adverse events, Clinically significant findings in physical examinations, vital signs, body weight and height, laboratory tests or 12-lead ECGs., Increase in suicide risk as assessed by the C-SSRS.
Endpoint(s): Change from primary study baseline in the CGI-C, PGI-C, CGI-S and PGI-S scores., Change from primary study baseline in the QOLIE-31 for adults and QOLIEAD- 48 for adolescents scores., Change from primary study baseline in the BDI-II scores., Based on seizure diary data with Baseline defined as the period before receiving study medication in the previous study (A_CL_002): - Mean percent change from baseline in monthly (28 days) seizures frequency. - Proportion of seizure free subjects per 28 days compared to baseline., Percentage of the cohort still on medication at months 6, 12, 18 and 24.

Source: https://euclinicaltrials.eu/ctis-public/view/2026-525161-40-00